EU clinical trial 2024-514435-20-00: A Phase 3b Open-Label Study of Long-Term Neurocognitive Outcomes in Children With Phenylketonuria Treated With Sepiapterin (EPIPHENY)
Protocol code: PTC923-PKU-401
Sponsor: PTC Therapeutics Inc. (Pharmaceutical company). Phase: Therapeutic confirmatory (Phase III). Countries: Ireland (ongoing, recruiting), Sweden (authorised, recruitment pending), Poland (ongoing, recruiting), France (ongoing, recruiting).
Therapeutic area(s): Phenomena and Processes [G] - Metabolism [G03]
Gender: Female, Male. Age: 0-17 years. Enrolment: 60.
Start date (EU): 2025-12-23. Decision date: 2025-07-14. Results received: No. Last updated: 2026-06-18.
Decision dates by country: IE: 2025-07-14, PL: 2025-07-18, SE: 2025-07-16, FR: 2025-07-18

Condition(s): Phenylketonuria
Product: Sephience 1 000 mg oral powder in sachet, Sephience 250 mg oral powder in sachet

Primary endpoint: Mean change in full-scale intelligence quotient (FSIQ) (WPPSI-IV or WISC-V) over a 2-year period: WPPSI-IV (Wechsler Preschool and Primary Scale of Intelligence - Fourth Edition): for participants ≥30 months to <6 years of age, WISC-V (Wechsler Intelligence Scale for Children - Fifth Edition): for participants ≥6 years to 16 years of age
Endpoint(s): 01. Change from baseline in phenylketonuriaquality of life (PKU-QOL) questionnaire score over time, 02. Change from baseline in European Quality of Life - 5 Dimensions (EQ-5D) score over time, 03. Mean change in FSIQ (WPPSI-IV or WISC-V) over a 4-year period, 04. Change of phenylalanine (Phe) levels over time

Source: https://euclinicaltrials.eu/ctis-public/view/2024-514435-20-00